EU clinical trial 2023-508704-37-00: Induced hypertension in acute PRogrESsive perforating artery Stroke Using peripheral dilute noREpinephrine
Protocol code: CHUBX 2022/23
Sponsor: Centre Hospitalier Universitaire De Bordeaux (Hospital/Clinic/Other health care facility). Phase: Therapeutic confirmatory (Phase III). Countries: France (ongoing, recruiting).
Therapeutic area(s): Diseases [C] - Nervous System Diseases [C10]
Gender: Female, Male. Age: 18-64 years, 65+ years. Enrolment: 358.
Status: Ongoing, recruiting. Start date (EU): 2024-11-08. Decision date: 2024-07-09. Results received: No. Last updated: 2026-07-24.

Condition(s): Stroke
Product: NORADRENALINE RENAUDIN 2 mg/ml SANS CONSERVATEUR, solution à diluer pour perfusion

Primary endpoint: Functional independence defined as modified Rankin Scale (mRS) 0-2, or return to pre-stroke mRS, assessed at 90 days
Endpoint(s): - Two outcomes will be used to assess 90-day functional outcomes: Ordinal (shift) modified Rankin scale at 90 days, and rate of 90-day excellent functional outcome (mRS 0-1), - Early neurological improvement defined as a reduction of at least 3 points on the National Institutes of Health Stroke Scale (NIHSS) at the end of NorEpinephrine (NE) infusion and at 7 days compared to the NIHSS at the NE initiation, or a NIHSS score of 0 or 1 at the end of NE infusion and at 7 days, evaluated by a stroke neurologist, - Mortality from any cause at 90 days, - Primary Care Post-Traumatic Stress Disorder Screen for DSM-5 (PC-PTSD-5) at 90 days, - Hospital Anxiety and Depression (HAD) Scale at 90 days, - Montreal Cognitive Assessment (MOCA) at 90 days, - The main predictive factor of interest is the achievement of the target pressure (at least 24h with a PAM between 110 and 120mmH)., - Symptomatic intracerebral hemorrhage defined by parenchymal hematoma type 2 combined with an increase in the NIHSS score of at least 4 points., - Norepinephrine (NE) extravasation associated with tissue injury requiring medical or surgical intervention (cf 10. Management of adverse events): peripheral intravenous must be assessed on initiation and every 1 hour while NE administration by nurses., - Acute coronary syndrome at 7 days, - Congestive heart failure at 7 days, - Tachyarrhythmia at 7 days, - Headache, during NE infusion., - Chest pain during NE infusion., - Bradycardia, - Dysuria during NE infusion., - Dyspnea during NE infusion., - The length of in-hospital stay will be measured from the date of admission in the emergency unit and the date of hospital discharge., - Rehabilitation will comprise need of hospitalization and length of stay in rehabilitation centers.

Source: https://euclinicaltrials.eu/ctis-public/view/2023-508704-37-00